EU clinical trial 2026-526044-12-00: Efficacy and safety of pharmacological therapy of obesity in liver transplant candidates
Sponsor: Institute For Clinical And Experimental Medicine (Hospital/Clinic/Other health care facility). Phase: Therapeutic use (Phase IV). Countries: Czechia (authorised, recruitment pending).
Therapeutic area(s): Diseases [C] - Digestive System Diseases [C06]
Gender: Female, Male. Age: 18-64 years, 65+ years. Enrolment: 40.
Status: Authorised, recruitment pending. Decision date: 2026-03-18. Results received: No. Last updated: 2026-03-18.

Condition(s): Obesity
Product: Mounjaro 5 mg solution for injection in pre-filled pen, Mounjaro 2.5 mg solution for injection in pre-filled pen

Primary endpoint: Absolute and relative change in body weight/BMI/body fat composition during the follow-up period.
Endpoint(s): Occurrence of complications while on the waiting list (WL) related to the underlying liver disease, Safety of treatment (adverse events), Post-transplant complications (1M, 3M, 6M), Patient survival (1M, 3M, 6M), Graft survival (1M, 3M, 6M)

Source: https://euclinicaltrials.eu/ctis-public/view/2026-526044-12-00